EU clinical trial 2023-503957-36-00: A 2-part, Multicenter, Randomized, Double-blind Study to Evaluate the Efficacy and Safety of Oral Difelikefalin for Moderate-to-Severe Pruritus in Adult Subjects with Notalgia Paresthetica
Protocol code: CR845-310601
Sponsor: Cara Therapeutics Inc. (Pharmaceutical company). Phase: Phase II and Phase III (Integrated). Countries: Spain (ended), Germany (ended), Poland (ended).
Therapeutic area(s): Diseases [C] - Nervous System Diseases [C10]; Diseases [C] - Skin and Connective Tissue Diseases [C17]
Gender: Female, Male. Age: 18-64 years, 65+ years. Enrolment: 193.
Status: Ended. Start date (EU): 2023-12-04. End date (EU): 2024-06-12. End date: 2024-06-13. Decision date: 2023-10-05. Results received: No. Last updated: 2024-04-29.
Decision dates by country: DE: 2023-10-10, ES: 2023-10-05, PL: 2023-10-11

Condition(s): Moderate-to-Severe pruritus in adult subjects with notalgia paresthetica
Product: Difelikefalin, Difelikefalin, Difelikefalin, Placebo

Primary endpoint: The percentage of patients achieving ≥4-point improvement from baseline in the weekly mean of the daily 24-hour Itch scores assessed on Day 2, at Week 1, 2, 4 and 8., The percentage of patients who are free or almost free of itch by achieving a weekly mean of the daily 24-hour Itch score of 0 to 1, inclusive at Week 8 (complete responder)., Mean change from baseline in the burning sensation scale at Week 8., Mean change from baseline in the skin tingling scale at Week 8., The percentage of patients with hyperpigmentation assessed as clear (0) or almost clear (1) at Week 8.
Endpoint(s): Number of adverse events that started after the end of treatment period based on daily assessment during the 2-week treatment discontinuation period., Safety evaluations, including number of adverse events during the study.

Source: https://euclinicaltrials.eu/ctis-public/view/2023-503957-36-00